EU clinical trial 2024-518857-41-00: Concomitant HPV vaccination and HPV screening for rapid elimination of HPV infection and cervical cancer in Sweden
Sponsor: Region Stockholm (Hospital/Clinic/Other health care facility). Phase: Therapeutic use (Phase IV). Countries: Sweden (ongoing, recruiting).
Therapeutic area(s): Diseases [C] - Neoplasms [C04]
Gender: Female. Age: 18-64 years. Enrolment: 150000.
Status: Ongoing, recruiting. Start date (EU): 2024-11-29. Decision date: 2024-11-29. Results received: No. Last updated: 2025-02-21.

Condition(s): HPV infection and related diseases, such as cervical intraepithelial neoplasia grade 2 and 3 and cervical cancer.
Product: Gardasil 9 suspension for injection in a pre-filled syringe. Human Papillomavirus 9-valent Vaccine (Recombinant, adsorbed)

Primary endpoint: Uptake of HPV vaccine in eligible women, by county and age strata.
Endpoint(s): Compliance with HPV vaccine administration Schedule.

Source: https://euclinicaltrials.eu/ctis-public/view/2024-518857-41-00